EU clinical trial 2025-522734-31-00: A Phase 2, Randomized, Double-Blind, Placebo-Controlled Trial to Evaluate the Safety, Tolerability, and Efficacy of TAK-755 in Acute Ischemic Stroke
Protocol code: TAK-755-2002
Sponsor: Takeda Development Center Americas Inc. (Pharmaceutical company). Phase: Therapeutic exploratory (Phase II). Countries: Greece (authorised, recruitment pending), Belgium (authorised, recruitment pending), France (not authorised), Germany (authorised, recruitment pending).
Therapeutic area(s): Diseases [C] - Nervous System Diseases [C10]
Gender: Female, Male. Age: 18-64 years, 65+ years. Enrolment: 67.
Decision date: 2026-07-14. Results received: No. Last updated: 2026-07-20.
Decision dates by country: BE: 2026-07-14, FR: 2026-07-20, DE: 2026-07-16, GR: 2026-07-16

Condition(s): Acute Ischemic Stroke
Product: Lyophilized product with the same form and functional characteristics as TAK-755, ADZYNMA 1 500 IU powder and solvent for solution for injection, ADZYNMA 1 500 IU powder and solvent for solution for injection, ADZYNMA 1 500 IU powder and solvent for solution for injection, ADZYNMA 1 500 IU powder and solvent for solution for injection

Primary endpoint: Parts A and B: Proportion of participants who develop symptomatic intracranial hemorrhage (sICH) within 120 hours after trial intervention, defined by the Heidelberg Bleeding Classification system.
Endpoint(s): Part A: Proportion of participants with treatment-related and unrelated treatment-emergent adverse events (TEAEs) and serious adverse events (SAEs) within 90 days. • Proportion of participants with severe TEAEs within 90 days. • Proportion of participants with life-threatening adverse events (AEs) within 90 days. • Proportion of participants with AEs of special interest (AESIs)., Part A continued: • Proportion of participants with clinically relevant changes in vital signs, clinical chemistry, and hematology. • Incidence of binding and neutralizing antibodies to ADAMTS13 from Day 30 to Day 90. • All-cause mortality within 90 days. • Proportion of participants with modified Rankin Scale (mRS) score of 0-1 at Day 90. • Proportion of participants with mRS score of 0-2 at Day 90. • Ordinal distribution of mRS at Day 90., Part A continued: • Change in National Institutes of Health Stroke Scale (NIHSS) score from baseline at 24 hours. • Proportion of participants with recanalization at 24 hours, defined as complete recanalization with an arterial occlusive lesion (AOL) score of 3. • Proportion of participants with reperfusion at 24 hours, defined as >90% reduction in volume of reversible ischemic tissue (penumbra) from baseline. • Final infarct volume at 72 hours or discharge (if earlier than 72 hours)., Part B: • Proportion of participants with mRS score of 0-1 at Day 90. • Proportion of participants with mRS score of 0-2 at Day 90 • Ordinal distribution of mRS at Day 90. • Change in NIHSS score from baseline at 24 hours., Part B continued: • Proportion of participants with recanalization at 24 hours, defined as complete recanalization with an AOL score of 3. • Proportion of participants with reperfusion at 24 hours, defined as >90% reduction in volume of reversible ischemic tissue (penumbra) from baseline. • Final infarct volume at 72 hours or hospital discharge (if earlier than 72 hours).

Source: https://euclinicaltrials.eu/ctis-public/view/2025-522734-31-00